EU clinical trial 2023-507942-10-00: A Phase II, 6-week, multi-centre, randomised, double-blind (participant and investigator), placebo-controlled, dose-finding trial to evaluate the efficacy, tolerability, and safety of different doses of oral BI 1569912 as adjunctive therapy in patients with major depressive disorder
Protocol code: 1447-0005
Sponsor: Boehringer Ingelheim International GmbH (Pharmaceutical company). Phase: Therapeutic exploratory (Phase II). Countries: Belgium (ended), Bulgaria (ended), Czechia (ended), Germany (ended).
Therapeutic area(s): Psychiatry and Psychology [F] - Behavior and Behavior Mechanisms [F01]
Gender: Female, Male. Age: 18-64 years, 65+ years. Enrolment: 46.
Status: Ended. Start date (EU): 2024-07-31. End date (EU): 2025-02-25. End date: 2025-03-11. Decision date: 2024-07-02. Results received: Yes. Last updated: 2025-02-10.
Decision dates by country: CZ: 2024-07-03, BG: 2024-07-05, DE: 2024-08-02, BE: 2024-07-02

Condition(s): Major depressive disorder

Primary endpoint: Change from baseline in MADRS total score at Week 6
Endpoint(s): Change from baseline in MADRS total score at Day 8, Response defined as ≥50% MADRS reduction from baseline at Day 8, Response defined as ≥50% MADRS reduction from baseline at Week 6, Remission defined as MADRS total score ≤10 at Week 6, Change from baseline in Symptoms of Major Depressive Disorder Scale (SMDDS) total score at Day 8, Change from baseline in SMDDS total score at Week 4

Source: https://euclinicaltrials.eu/ctis-public/view/2023-507942-10-00